EU clinical trial 2024-519773-19-00: A Phase 3, Double-blind, Randomized Study of Zolbetuximab in Combination with Pembrolizumab and Chemotherapy (CAPOX or mFOLFOX6) in First-line Treatment of Locally Advanced Unresectable or Metastatic Gastric or Gastroesophageal Junction Adenocarcinoma in Participants Whose Tumors are HER2-negative, Claudin (CLDN) 18.2-positive and Programmed Death-ligand 1 (PD-L1)-positive
Protocol code: 8951-CL-0305
Sponsor: Astellas Pharma Global Development Inc. (Pharmaceutical company). Phase: Therapeutic confirmatory (Phase III). Countries: Spain (ongoing, recruitment ended), Poland (ongoing, recruitment ended), Netherlands (ongoing, recruitment ended), France (ongoing, recruitment ended), Portugal (ongoing, recruitment ended), Romania (ongoing, recruitment ended), Germany (ongoing, recruitment ended), Lithuania (ongoing, recruitment ended), Czechia (ongoing, recruitment ended), Belgium (ongoing, recruitment ended), Italy (ongoing, recruitment ended).
Therapeutic area(s): Diseases [C] - Digestive System Diseases [C06]; Diseases [C] - Neoplasms [C04]
Gender: Female, Male. Age: 18-64 years, 65+ years. Enrolment: 201.
Status: Ongoing, recruitment ended. Start date (EU): 2025-07-31. Decision date: 2025-07-08. Results received: No. Last updated: 2026-04-09.
Decision dates by country: PL: 2025-07-14, PT: 2025-07-08, BE: 2025-07-09, IT: 2025-07-09, NL: 2025-07-14, LT: 2025-07-09, FR: 2025-07-15, RO: 2025-07-14, CZ: 2025-07-08, DE: 2025-07-10, ES: 2025-07-11

Condition(s): Gastroesophageal Junction Adenocarcinoma, Gastric Cancer, Gastric Adenocarcinoma
Product: Vyloy 100 mg powder for concentrate for solution for infusion., OXALIPLATIN, FOLINIC ACID, KEYTRUDA 25 mg/mL concentrate for solution for infusion, CAPECITABINE, FLUOROURACIL, KEYTRUDA 25 mg/mL concentrate for solution for infusion., KEYTRUDA 25 mg/mL concentrate for solution for infusion., Vyloy 100 mg powder for concentrate for solution for infusion., KEYTRUDA 25 mg/mL concentrate for solution for infusion., Sodium chloride 0.9% intravenous infusion, ASP8951, CAPECITABINE, KEYTRUDA 25 mg/mL concentrate for solution for infusion.

Primary endpoint: Overall Survival, defined as the time from the date of randomization until the documented date of death from any cause
Endpoint(s): Progression-free survival, defined as the time from the date of randomization until the date of radiologic disease progression (investigator-assessed per RECIST V1.1) or death from any cause, whichever is earlier, Objective response rate, defined as the proportion of participants who have a best overall response of complete response or partial response as investigator-assessed per RECIST V1.1, Duration of response, defined as the time from the date of the first response (complete response/partial response) until the date of disease progression as investigator-assessed per RECIST V1.1 or date of death from any cause, whichever is earlier, Safety and tolerability of zolbetuximab in combination with pembrolizumab and chemotherapy as evaluated by adverse events, electrocardiogram, vital signs, Eastern Cooperative Oncology Group performance status and safety laboratory assessments (NCI-CTCAE version 5.0), Serum concentrations of zolbetuximab: end of infusion concentrations and concentration immediately prior to dosing at multiple dosing, Measurement of frequency of antidrug antibody-positive participants

Source: https://euclinicaltrials.eu/ctis-public/view/2024-519773-19-00